EU clinical trial 2024-520436-15-00: Phase I/II study of anti-GD2 Chimeric Antigen Receptor-Expressing T cells in pediatric patients affected by High Risk and/or relapsed/refractory Neuroblastoma and other relapsed/refractory GD2+ tumors
Protocol code: GD2CAR01
Sponsor: Ospedale Pediatrico Bambino Gesu (Hospital/Clinic/Other health care facility). Phase: Phase I and Phase II (Integrated)- First administration to humans. Countries: Italy (ongoing, recruiting).
Therapeutic area(s): Diseases [C] - Neoplasms [C04]
Gender: Female, Male. Age: 0-17 years, 18-64 years. Enrolment: 54.
Status: Ongoing, recruiting. Start date (EU): 2025-02-18. Decision date: 2025-02-17. Results received: No. Last updated: 2025-02-17.

Condition(s): High Risk and/or relapsed/refractory Neuroblastoma and other relapsed/refractory GD2+ tumors
Product: CYCLOPHOSPHAMIDE, FLUDARABINE

Primary endpoint: Phase I primary end-points 1. To evaluate the safety of the infusion of iC9-GD2-CAR T cells at different escalating/de-escalating doses and establish the dose limiting toxicity (DLT) of the cellular product. Toxicity will be evaluated according to the Common Terminology Criteria for Adverse Event (CTC AE) scale, version 4.0. DLT will be defined as any of the following that is not pre-existing, due to infection or to underlying malignancy and that may be considered possibly, probably or definite
Endpoint(s): Phase I and II secondary end-points 1. To assess the in vivo persistence and expansion of the infused T cells in the peripheral blood (PB), BM and in the Cerebro-Spinal Fluid (CSF) using immunoassays and transgene detection (Real Time qPCR), both for the whole population and the specific T cells subsets. 2. To evaluate the tumor infiltration of the infused T cells through Immunohistochemistry (IHC), flow cytometry and/or transgene detection (Real Time qPCR), whenever the tumor sample is availa

Source: https://euclinicaltrials.eu/ctis-public/view/2024-520436-15-00